EU clinical trial 2025-520629-19-00: An exploratory study to investigate the impact on the viral reservoir of adding a broadly neutralizing antibody with or without an attachment inhibitor to an integrase inhibitor-based antiretroviral therapy regimen in adults living with HIV (ENTRANCE)
Protocol code: 221794
Sponsor: Viiv Healthcare UK Limited (Pharmaceutical company). Phase: Human Pharmacology (Phase I)- Other. Countries: Netherlands (ongoing, recruitment ended), Spain (ongoing, recruitment ended), Belgium (ongoing, recruitment ended), Denmark (ongoing, recruitment ended).
Therapeutic area(s): Diseases [C] - Virus Diseases [C02]
Gender: Female, Male. Age: 18-64 years, 65+ years. Enrolment: 73.
Status: Ongoing, recruitment ended. Start date (EU): 2025-10-01. Decision date: 2025-09-22. Results received: No. Last updated: 2026-08-07.
Decision dates by country: ES: 2025-09-26, BE: 2025-09-23, NL: 2025-09-23, DK: 2025-09-22

Condition(s): HIV Infections

Source: https://euclinicaltrials.eu/ctis-public/view/2025-520629-19-00